EU clinical trial 2024-517015-73-00: Muscle strength and -mass after bariatric surgery - a possible effect of testosterone replacement therapy? Randomized, placebo-controlled and double-blinded study
Sponsor: Esbjerg Og Grindsted Sygehus (Hospital/Clinic/Other health care facility). Phase: Therapeutic use (Phase IV). Countries: Denmark (ended).
Therapeutic area(s): Diseases [C] - Hormonal diseases [C19]
Gender: Male. Age: 18-64 years. Enrolment: 64.
Status: Ended. Start date (EU): 2020-12-15. End date (EU): 2025-11-06. Decision date: 2024-09-20. Results received: No. Last updated: 2024-09-20.

Condition(s): Adipositas and male hypogonadism
Product: Nebido 1000 mg Injektionslösung, Placebo oily solution to Testosterone undecanoate oily solution 0.25 g/mL 4 mL in ampoule for intramuscular use (NEBIDO)

Primary endpoint: Maximal isometric muscle strength (N) in shoulder muscles (shoulder elevation.
Endpoint(s): Regional body composition (DXA scan, BMI, Waist/hip-ratio) - Physical strength: maximal isometric muscle strength in lower extremities (hip extension, hip abduction), muscle strength in upper-extremities (shoulder abduction, shoulder adduction) - Physical function: performance-based measures of physical function (stair climb test) and maximal oxygen uptake (VO2max). - Glucose metabolism (HOMA-R, HbA1c, Fasting-P-Blood glucose) - Coagulation/fibrinolysis status (thrombin generation measures) - Ad

Source: https://euclinicaltrials.eu/ctis-public/view/2024-517015-73-00